EU clinical trial 2024-518915-20-00: Intraclass safety and efficacy comparison among SGLT-2 inhibitors in elderly patients with type 2 diabetes. A pragmatic, phase IV, multicenter, open-label, randomised controlled trial.
Protocol code: TRS-2019-00002051
Sponsor: Center For Outcomes Research And Clinical Epidemiology S.r.l. (Pharmaceutical company). Phase: Therapeutic use (Phase IV). Countries: Italy (ended).
Therapeutic area(s): Diseases [C] - Nutritional and Metabolic Diseases [C18]
Gender: Female, Male. Age: 65+ years. Enrolment: 1167.
Status: Ended. Start date (EU): 2022-02-16. End date (EU): 2025-10-02. Decision date: 2024-11-13. Results received: No. Last updated: 2025-09-30.

Condition(s): Type 2 diabetes mellitus
Product: Invokana 100 mg film-coated tablets, Xigduo 5 mg/850 mg film-coated tablets, Vokanamet 150 mg/850 mg film-coated tablets, Forxiga 10 mg film-coated tablets, Vokanamet 50 mg/1,000 mg film-coated tablets, Invokana 300 mg film-coated tablets, Forxiga 5 mg film-coated tablets, Vokanamet 50 mg/850 mg film-coated tablets, Synjardy 12.5 mg/1,000 mg film-coated tablets, Synjardy 12.5 mg/850 mg film-coated tablets, Jardiance 25 mg film-coated tablets, Synjardy 5 mg/1,000 mg film-coated tablets, Xigduo 5 mg/1,000 mg film-coated tablets, Synjardy 5 mg/850 mg film-coated tablets, Vokanamet 150 mg/1,000 mg film-coated tablets, Jardiance 10 mg film-coated tablets

Primary endpoint: Glucose control without level-3 hypoglycemia
Endpoint(s): Glucose control without level-2 hypoglycemia, Change in HbA1c glycemic and extraglycemic endpoints, Change in HbA1c, Change in body weight, Change in systolic blood pressure, Change in eGFR, Change in the use of concomitant medications, Change in the dosage of concomitant medications, Change in treatment satisfaction, Safety: - Hospitalization for any cause, - Hospitalization for heart failure, - Hospitalization for cardiovascular causes, - All-cause death - Cardiovascular death - Severe hypoglycemia - Genitourinary tract infections - Dehydration / hypovolemia events - Bone fractures; - Leg/foot amputations - Diabetic ketoacidosis

Source: https://euclinicaltrials.eu/ctis-public/view/2024-518915-20-00